EU clinical trial 2023-504441-31-00: A multicentric phase 1/2 trial to evaluate the safety and efficacy of SOT102 as monotherapy and in combination with standard of care treatment in patients with gastric and pancreatic adenocarcinoma
Protocol code: SN201(CLAUDIO-01)
Sponsor: SOTIO Biotech a.s. (Pharmaceutical company). Phase: Phase I and Phase II (Integrated)- First administration to humans. Countries: Spain (ended), Czechia (ended), France (ended), Belgium (ended).
Therapeutic area(s): Diseases [C] - Neoplasms [C04]
Gender: Female, Male. Age: 18-64 years, 65+ years. Enrolment: 205.
Status: Ended. Start date (EU): 2022-06-29. End date (EU): 2024-12-13. Decision date: 2023-08-02. Results received: Yes. Last updated: 2024-07-15.
Decision dates by country: FR: 2023-09-05, BE: 2023-09-11, ES: 2023-08-03, CZ: 2023-08-02

Condition(s): gastric adenocarcinoma or adenocarcinoma of the gastroesophageal junction (GEJ) and pancreatic adenocarcinoma
Product: Folinic Acid (as Calcium Folinate) 10 mg/ml Solution for Injection, Abraxane 5 mg/ml powder for dispersion for infusion., Oxaliplatin 5 mg/ml concentrate for solution for infusion, OPDIVO 10 mg/mL concentrate for solution for infusion., Gemcitabine 1 g powder for solution for infusion, Fluorouracil 25 mg/ml Solution for Injection or Infusion

Primary endpoint: Part A and B •To determine the maximum tolerated dose (MTD) and recommended phase 2 dose (RP2D) of SOT102 given as monotherapy and in combination with first-line standard of care (SoC) treatment. MTD is defined as the highest dose level tested below the dose level associated with ≥33% of dose-limiting toxicity (DLT)-evaluable patients experiencing DLT. The RP2D will be selected based on integrated evaluation of the totality of clinical and preclinical data, for all dose levels tested., Part C and D •To assess the efficacy of SOT102 in monotherapy and in combination with first-line SoC treatment by objective response rate
Endpoint(s): The occurrence of DLTs, occurrence of treatment-emergent AEs (TEAEs), SOT102- related AEs, serious AEs (SAEs), AEs leading to premature discontinuation of SOT102, deaths, or clinical laboratory test abnormalities, PK of total SOT102, conjugated SOT102, PNU159682, PNU-EDA, -EDA-GGT (M4), PNU-EDA-GG (M5), and PNU-EDA-G (M6), Anecdotal tumor response per Response Evaluation Criteria in Solid Tumors (RECIST) 1.1 by type and CLDN18.2 expression. The number of patients with detected antibodies against any part of SOT102, Additionally for Part C & Part D DoR, PFS and clinical benefit rate per RECIST 1.1, OS Assessment of global and disease-specific QoL by patient-reported questionnaires EORTC QLQ-C30 and EORTC QLQ-STO22 for patients with gastric cancer, and EORTC QLQC30 and EORTC QLQ-PAN26 for patients with pancreatic cancer

Source: https://euclinicaltrials.eu/ctis-public/view/2023-504441-31-00